EU clinical trial 2024-516916-93-00: A phase 1B, multicenter, open-label study of Valemetostat Tosylate in combination with DXd ADCs in subjects with solid tumors(study of Valemetostat Tosylate in combination with DXd ADCs)
Protocol code: DS3201-324
Sponsor: Daiichi Sankyo Inc. (Pharmaceutical company). Phase: Human Pharmacology (Phase I)- Other. Countries: Italy (temporarily halted), France (ended), Spain (temporarily halted).
Therapeutic area(s): Diseases [C] - Neoplasms [C04]
Gender: Female, Male. Age: 18-64 years, 65+ years. Enrolment: 45.
Start date (EU): 2025-09-08. Decision date: 2025-06-24. Results received: No. Last updated: 2026-04-15.
Decision dates by country: FR: 2025-06-26, ES: 2025-06-24, IT: 2025-06-26

Condition(s): This study will be a Phase 1b, global, multicenter, open-label, 2-part study of valemetostat in combination with DXd ADCs. The Master Protocol study design contains independent subprotocols, which have been defined by treatment combination and subject population, as follows: Sub-protocol A: Valemetostat in combination with T-DXd in subjects with previously treated, unresectable and/or metastatic HER2-low (immunohistochemistry[IHC] 1+ or IHC 2+/in situ hybridization [ISH]-negative) BC; for details, see Sub-protocol A. Sub-protocol B: Valemetostat in combination with T-DXd in subjects with previously treated, advanced or metastatic HER2-positive gastric or GEJ adenocarcinoma; for details, see Sub-protocol B. Sub-protocol C: Valemetostat in combination with Dato-DXd in subjects with previously treated, locally advanced, unresectable, or metastatic non-squamous NSCLC with or without actionable genomic alteration(s); for details, see Sub-protocol C.
Product: Valemetostat Tosylate, DS-8201a, Datopotamab deruxtecan, Valemetostat Tosylate, Valemetostat Tosylate

Primary endpoint: Number of Participants Reporting Dose-limiting Toxicities (Part 1 Dose Escalation), Number of Participants Reporting Treatmentemergent Adverse Events (Part 1 Dose Escalation), Objective Response Rate Based on Investigator Assessment (Part 2 Dose Expansion)
Endpoint(s): Overall survival, Progression-free Survival, Duration of Response (DoR), Objective Response Rate Based on Investigator Assessment (Part 1 Dose Escalation), Number of Participants Reporting Treatment-emergent Adverse Events (Part 2 Dose Expansion), Total and Unbound Plasma Concentration of Valemetostat, Plasma Concentration of DXd Antibody-Drug Conjugates

Source: https://euclinicaltrials.eu/ctis-public/view/2024-516916-93-00